EU clinical trial 2024-517261-16-00: A Phase I/II, open-label, adaptive two-part trial to evaluate the safety, efficacy, optimal dose and pharmacokinetics of BNT326 as monotherapy and in combination with cancer immunotherapies in participants with advanced solid tumors
Protocol code: BNT326-01
Sponsor: BioNTech SE (Pharmaceutical company). Phase: Phase I and Phase II (Integrated)- Other. Countries: Belgium (ongoing, recruiting), Germany (ongoing, recruiting), Spain (ongoing, recruiting), Italy (ongoing, recruiting).
Therapeutic area(s): Diseases [C] - Neoplasms [C04]
Gender: Female, Male. Age: 18-64 years, 65+ years. Enrolment: 329.
Status: Ongoing, recruiting. Start date (EU): 2025-12-05. Decision date: 2025-10-17. Results received: No. Last updated: 2026-04-13.
Decision dates by country: ES: 2025-10-20, IT: 2025-10-22, BE: 2025-10-21, DE: 2025-10-17

Condition(s): Advanced solid tumors
Product: BNT327 1-15, BNT327, BNT326

Primary endpoint: For Part I (monotherapy): Occurrence of treatment-emergent adverse events (TEAEs), treatment-emergent related adverse events (TRAEs), treatment-emergent serious adverse events (TESAEs), and treatment-emergent related serious adverse events (TRSAEs), by cohort and dose, from the time of initiation of the first dose of IMP to 42 days after the last dose of IMP or until a new anti-cancer therapy is started., For Part I (monotherapy): Occurrence of dose interruption, reduction, and treatment discontinuations due to TEAEs, by cohort and dose, from the time of initiation of the first dose of IMP to 42 days after the last dose of IMP or until a new systemic anti-cancer therapy is started, whichever occurs first., For Part I (monotherapy): Confirmed objective response rate (ORR), defined as the proportion of participants in whom a confirmed complete response (CR) or partial response (PR) based on the investigator’s assessment (per RECIST 1.1) is observed as best overall response, by cohort and dose., Part 2 (combination therapy): Occurrence of treatment-emergent adverse events (TEAEs), treatment-emergent related adverse events (TRAEs), treatment-emergent serious adverse events (TESAEs), and treatment-emergent serious related adverse events (TRSAEs), and dose interruption, reduction, and discontinuation due to TEAEs, by cohort and dose., Part 2 (combination therapy): Occurrence of dose-limiting toxicities (DLTs) during the DLT observation period., Part 2 (combination therapy): Confirmed objective response rate (ORR), defined as the proportion of participants in whom a confirmed complete response (CR) or partial response (PR) per RECIST 1.1 based on the investigator’s assessment, is observed as best overall response, by cohort and combination treatment regimen.
Endpoint(s): Parts 1 and 2: Progression-free survival (PFS), based on the investigator’s assessment, defined as the time from first dose of IMP to the first objective tumor progression (progressive disease (PD) per RECIST 1.1) or death from any cause, whichever occurs first, by cohort and combination treatment regimen., Parts 1 and 2: Depth of response (DpR) defined as the maximum percent reduction from baseline in tumor size measured by sum of target lesion diameter, by cohort and combination treatment regimen., Parts 1 and 2: Disease control rate (DCR) defined as the proportion of participants with a confirmed complete response (CR), partial response (PR), or a stable disease (per RECIST 1.1 based on the investigator’s assessment) as best overall response, by cohort and combination treatment regimen., Parts 1 and 2: Duration of response (DOR) defined as the time from first objective response (CR or PR per RECIST 1.1 based on the investigator’s assessment) to first occurrence of objective tumor progression (PD per RECIST 1.1 based on the investigator’s assessment) or death from any cause, whichever occurs first, by cohort and combination treatment regimen., Parts 1 and 2: Time to response (TTR) defined as the time from first dose of IMP to first objective response (CR or PR per RECIST 1.1 based on the investigator’s assessment), by cohort and combination treatment regimen., Parts 1 and 2: Overall survival (OS) defined as the time from first dose of IMP to death from any cause, by cohort and combination treatment regimen., Parts 1 and 2: Pharmacokinetic (PK) parameters derived from serum concentrations of BNT326 ADC, total anti-HER3 antibody component, and unconjugated payload YL0010014 component, by cohort and combination treatment regimen., Parts 1 and 2: Anti-drug antibody (ADA) prevalence and ADA incidence up to 1 year from the last dose of IMP, by cohort and combination treatment regimen.

Source: https://euclinicaltrials.eu/ctis-public/view/2024-517261-16-00